EU clinical trial 2025-521683-35-00: GUselkumAb inteRvention and DIet evaluAtioN for pouchitis
Sponsor: UZ Leuven (Hospital/Clinic/Other health care facility). Phase: Therapeutic use (Phase IV). Countries: Belgium (ongoing, recruiting).
Therapeutic area(s): Diseases [C] - Nutritional and Metabolic Diseases [C18]; Diseases [C] - Digestive System Diseases [C06]; Diseases [C] - Immune System Diseases [C20]
Gender: Female, Male. Age: 18-64 years, 65+ years. Enrolment: 20.
Status: Ongoing, recruiting. Start date (EU): 2026-04-21. Decision date: 2026-03-19. Results received: No. Last updated: 2026-03-31.

Condition(s): Pouchitis
Product: Guselkumab

Primary endpoint: the percentage of subjects with chronic or recurrent pouchitis achieving clinical remission (mPDAI score <5 and a reduction of overall score by ≥2 points from Baseline) after 16 weeks of treatment with guselkumab compared to 16 weeks of guselkumab and a dietary intervention
Endpoint(s): The percentage of subjects achieving clinical remission (mPDAI score <5 and a reduction of overall score by ≥2 points from Baseline) after 48 weeks in both groups, The percentage of subjects achieving antibiotic free clinical remission by week 16 and 48, The percentage of subjects achieving partial response (reduction of mPDAI score by ≥2 points from Baseline) after 16 and 48 weeks in both groups, Time to clinically relevant remission in both groups, Change in mPDAI endoscopic subscore at Week 16 and 48 compared to Baseline in both groups, Change in mPDAI histologic subscore at Week 16 and 48 compared to Baseline in both groups, Change in total mPDAI score at Week 16 and 48 compared to Baseline in both groups, The percentage of subjects achieving a (endoscopic proven) flare after initial response in both groups, Changes in intestinal microbiota (metagenomic microbiota profiling) at Week 8, 16, 24, 32, 40 and 48 compared to Baseline in both groups, Changes in IL-23p19 expression in the tissue at Week 16 and 48 compared to Baseline in both groups, Association between IL-23p19 expression and response to therapy in both groups, Compliance to the prescribed diet with food record and food frequency questionnaire in the group with the dietary intervention, Safety of the prescribed diet in the group with the dietary intervention, Tolerability of the prescribed diet with questionnaire in the group with the dietary intervention, Time to relapse of pouchitis symptoms and number of relapses in both groups, Change in CRP at Week 8, 16, 24, 32, 40 and 48 compared to Baseline in both groups, Change in faecal calprotectin at Week 8, 16, 24, 32 and 48 compared to Baseline in both groups, Evolution of guselkumab serum levels and anti-guselkumab antibodies between Baseline and Week 8, 16, 24, 32, 40 and 48 in both groups, Correlation of guselkumab serum levels and anti-guselkumab antibodies with clinical, endoscopic and histological outcomes between Baseline and Week 8, 16, 24, 32, 40 and 48 in both groups

Source: https://euclinicaltrials.eu/ctis-public/view/2025-521683-35-00